EU clinical trial 2023-508764-30-00: A Phase I study of STA551 and STA551 in combination with atezolizumab in patients with solid tumours
Protocol code: STA101JG
Sponsor: Chugai Pharmaceutical Co. Ltd. (Pharmaceutical company). Phase: Human Pharmacology (Phase I)- First administration to humans. Countries: Spain (ended), Poland (ended), Romania (ongoing, recruitment ended).
Therapeutic area(s): Diseases [C] - Neoplasms [C04]
Gender: Female, Male. Age: 18-64 years, 65+ years. Enrolment: 30.
Start date (EU): 2024-07-31. Decision date: 2023-12-18. Results received: No. Last updated: 2026-03-31.
Decision dates by country: PL: 2024-03-04, ES: 2023-12-18, RO: 2024-12-16

Condition(s): Locally advanced or metastatic solid tumors

Source: https://euclinicaltrials.eu/ctis-public/view/2023-508764-30-00